EU clinical trial 2023-508093-28-00: Targeting mTOR with everolimus and/or physical training for preventing postmenopausal bone loss and accelerated skeletal aging. The RapaLoad study.
Protocol code: 2023-508093-28-00
Sponsor: Odense University Hospital (Hospital/Clinic/Other health care facility). Phase: Therapeutic exploratory (Phase II). Countries: Denmark (ongoing, recruiting).
Therapeutic area(s): Diseases [C] - Hormonal diseases [C19]
Gender: Female. Age: 18-64 years. Enrolment: 136.
Status: Ongoing, recruiting. Start date (EU): 2024-10-20. Decision date: 2024-08-09. Results received: No. Last updated: 2025-03-14.

Condition(s): Healthy
Product: EVEROLIMUS

Primary endpoint: - Percentage change in circulating levels of bone formation marker N-terminal fragment of procollagen type 1 (P1NP) at 24 weeks as compared with baseline.
Endpoint(s): - Change in circulating levels of bone turnover markers: 1)Bone resorption markers (C-terminal telopeptide of type 1 collagen (CTX) and Tartrate resistant acid phosphatase (TRAcP)) at baseline, 4, 12 and 24 weeks. 2) Bone formation markers (osteocalcin, and bone alkaline phosphatase) at baseline, 4, 12 and 24 weeks and P1NP at 4 and 12weeks, - Lumbar spine (L1-4), and total hip and femoral neck bone mineral density (BMD) meas-ured by dual-energy X-ray absorptiometry (DXA) at baseline and 24 weeks, - Bone microarchitecture, mass, and geometry at the distal radius and tibia assessed us-ing high-resolution peripheral quantitative computed tomography (HR-pQCT) at base-line and 24 weeks, - Muscle function and postural balances tested at base-line and 24 weeks, - Cardiopulmonary health estimated by measuring Vo2max at baseline and week 24., - Metabolic health: weight, body composition by DXA scanning, fasting blood glucose, fasting insulin, lipid parameters and metabolomic studies at baseline and week 24.

Source: https://euclinicaltrials.eu/ctis-public/view/2023-508093-28-00